EU clinical trial 2024-516149-38-00: A Randomized Phase IIb Study, Evaluating Efficacy of Salvage Therapy with Brentuximab Vedotin-ESHAP vs ESHAP in Patients with Relapsed / Refractory Classical Hodgkin’s Lymphoma, Followed by Brentuximab Vedotin Consolidation (instead of Autologous Hematopoietic Stem Cell Transplantation) in Those who Attained a Metabolic Complete Remission after Salvage Therapy
Sponsor: Fundacion Geltamo (Patient organisation/association). Phase: Therapeutic exploratory (Phase II). Countries: Austria (ongoing, recruitment ended), Spain (ongoing, recruitment ended), Croatia (ongoing, recruitment ended), Greece (ongoing, recruitment ended).
Therapeutic area(s): Diseases [C] - Neoplasms [C04]
Gender: Female, Male. Age: 18-64 years. Enrolment: 149.
Status: Ongoing, recruitment ended. Start date (EU): 2024-10-29. Decision date: 2024-10-29. Results received: No. Last updated: 2025-01-22.
Decision dates by country: AT: 2024-11-12, HR: 2024-12-10, GR: 2025-01-22, ES: 2024-10-29

Condition(s): Hodgkin Lymphoma
Product: ADCETRIS 50 mg powder for concentrate for solution for infusion

Primary endpoint: Treatment response based on Deauville scores 1, 2, 3 (Complete metabolic response) by PET-CT scan After the 3 first cycles of BV-ESHAP or ESHAP
Endpoint(s): Two years Progression Free Survival (PFS): time from entry onto the study until lymphoma progression or death as a result of any cause, Two years Overall Survival (OS): time from entry onto the clinical trial until death as a result of any cause., Duration of response (DOR): time from first documentation of CR or PR to disease progression or death from any cause, whichever occurs first, Time to Progression (TTP): time from study entry until lymphoma progression or death as a result of lymphoma, Time to Next Treatment (TTNT): time from the end of primary treatment until the onset of the next therapy, Time to Next Treatment 2 (TTNT2): time from study enrollment to initiation of second line of therapy due to disease progression, Overall response rate, complete response rate after the 3 first cycles of BV-ESHAP or ESHAP, Prognostic impact of metabolic tumor volume, Quality of life of patients, Safety and tolerability As assessed by type, frequency, and severity for AEs and relationship with study treatment of AEs Focusing on fertility (evaluated yearly up to 3 years from the end of treatmentand secondary malignancies (3 years follow up for secondary malignancies

Source: https://euclinicaltrials.eu/ctis-public/view/2024-516149-38-00